EU clinical trial 2023-510495-31-00: A study in healthy people to see how zongertinib is taken up into the blood when given as tablets made by two different manufacturers
Protocol code: 1479-0019
Sponsor: Boehringer Ingelheim International GmbH (Pharmaceutical company). Phase: Human Pharmacology (Phase I)- Bioequivalence Study. Countries: Germany (ended).
Therapeutic area(s): Not possible to specify
Gender: Female, Male. Age: 18-64 years. Enrolment: 56.
Status: Ended. Start date (EU): 2024-04-24. End date (EU): 2024-07-15. Decision date: 2024-04-05. Results received: No. Last updated: 2024-07-09.

Condition(s): Healthy volunteer trial

Source: https://euclinicaltrials.eu/ctis-public/view/2023-510495-31-00